EU clinical trial 2024-514523-42-00: Comparison of inclisiran or alirocumab to standard therapy in pediatric heterozygous familial hypercholesterolemia (HeFH) – the head-to-head PICOLO-FH clinical trial
Protocol code: 2023-001
Sponsor: Medical University Of Lodz (Educational Institution). Phase: Therapeutic confirmatory (Phase III). Countries: Poland (ongoing, recruiting).
Therapeutic area(s): Diseases [C] - Cardiovascular Diseases [C14]; Diseases [C] - Nutritional and Metabolic Diseases [C18]
Gender: Female, Male. Age: 0-17 years. Enrolment: 400.
Status: Ongoing, recruiting. Start date (EU): 2025-06-05. Decision date: 2025-02-10. Results received: No. Last updated: 2026-06-23.

Condition(s): heterozygous familial hypercholesterolemia
Product: ALIROCUMAB, INCLISIRAN, ALIROCUMAB, ROSUVASTATIN

Primary endpoint: Number and % of study participants who achieved the therapeutic goal of LDL-C <100 mg/dl (<2.59 mmol/L) at the visit after 104 weeks of treatment (V 13).
Endpoint(s): Number and % of study participants who achieved the therapeutic goal of LDL-C <100 mg/dl (<2.59 mmol/L) at visits after 24 (V6) and 60 weeks of treatment (V9)., Absolute and percentage change in the following parameters after 24 weeks (V6), 60 weeks (V9) and 104 weeks of treatment (V13): LDL cholesterol, total cholesterol, non-HDL cholesterol, triglycerides, lipoprotein (a), apolipoprotein B, apolipoprotein A1 - relative to pre-treatment measurement with study drug (V4)., Change in CIMT (expressed in mm and z-score) after 104 weeks of treatment (V13) versus baseline measurement (V3)., Absolute values and change (absolute) from baseline for total score based on the PedsQL questionnaire at baseline visit (V3) and after 24 weeks (V6), 60 (V9) and 104 weeks of treatment (V13).

Source: https://euclinicaltrials.eu/ctis-public/view/2024-514523-42-00